EU clinical trial 2025-522545-22-00: Comparison of esketamine mouthwash versus intravenous administration for the treatment of chemotherapy/radiotherapy-induced mucositis
Protocol code: 2025-005
Sponsor: Amsterdam UMC Stichting (Patient organisation/association). Phase: Therapeutic exploratory (Phase II). Countries: Netherlands (authorised, recruitment pending).
Therapeutic area(s): Analytical, Diagnostic and Therapeutic Techniques and Equipment [E] - Anesthesia and Analgesia [E03]
Gender: Female, Male. Age: 18-64 years, 65+ years. Enrolment: 40.
Status: Authorised, recruitment pending. Decision date: 2026-03-13. Results received: No. Last updated: 2026-03-13.

Condition(s): Oral mucositis
Product: Esketamine HCl (Mouthwash), Esketamine Orifarm 5 mg/ml injektions-/infusionsvätska, lösning

Primary endpoint: Average oral and pharyngeal pain score (Numerical Rating Scale, NRS) at 1-hour post-first dose, compared between treatment arms to assess non-inferiority. Esketamine mouthwash will be declared non-inferior if the upper bound of the two-sided 95% confidence interval for the difference (mouthwash – IV) is < 1.3 NRS points.
Endpoint(s): Number and severity of treatment-emergent adverse events (AEs) and serious adverse events (SAEs), graded using CTCAE v5.0, during the treatment period., Change in average oral and pharyngeal pain score (NRS) from baseline to end of treatment., Daily assessment of oral intake and use of tube feeding or parenteral nutrition, summarized at end of treatment., Scores on the Daily Oral Mucositis Questionnaire (DOMQ), assessed daily and summarized at end of treatment., Frequency, severity, and type of local and systemic side effects, as reported by patients using a standardized 4-point Likert-scale questionnaire, completed daily during the treatment period. Clinical staff will also record any observed side effects., Total morphine-equivalent dose administered during the treatment period., Total number of hospital days from randomization to discharge., Total number of treatment days completed (length of treatment), number of missed doses or pauses (breaks in treatment), and documentation of early termination or discontinuation including reasons., Plasma concentrations of esketamine and norketamine at predefined time points, analyzed to assess systemic exposure and metabolism for each administration route.

Source: https://euclinicaltrials.eu/ctis-public/view/2025-522545-22-00